EU clinical trial 2022-501478-21-00: J2T-MC-KGBJ/DRM06-AD16 A Phase 3, Multicenter, Long-Term Extension Study to Assess the Safety and Efficacy of Lebrikizumab in Participants 6 Months to <18 Years of Age With Moderate-to-Severe Atopic Dermatitis
Sponsor: Eli Lilly & Co. (Pharmaceutical company). Phase: Therapeutic confirmatory (Phase III). Countries: Spain (ongoing, recruiting), Poland (ongoing, recruiting), France (authorised, recruitment pending), Germany (ongoing, recruiting), Czechia (ongoing, recruiting).
Therapeutic area(s): Diseases [C] - Skin and Connective Tissue Diseases [C17]
Gender: Female, Male. Age: 0-17 years. Enrolment: 87.
Start date (EU): 2024-03-15. Decision date: 2023-08-02. Results received: No. Last updated: 2026-06-26.
Decision dates by country: FR: 2023-09-21, ES: 2023-08-01, DE: 2023-08-02, CZ: 2023-08-03, PL: 2023-08-04

Condition(s): Atopic Dermatitis; Eczema
Product: Lebrikizumab, Placebo to match LY3650150

Primary endpoint: Percentage of Participants Discontinued from Study Treatment due to Adverse Events (AEs)

Source: https://euclinicaltrials.eu/ctis-public/view/2022-501478-21-00